EU clinical trial 2023-508988-73-00: "Full title (English): A Phase 3, open-label, single-arm, repeated-dose study to evaluate the safety and tolerability, pharmacokinetics, and antiviral activity of maribavir for the treatment of cytomegalovirus (CMV) infection in children and adolescents who have received a hematopoietic stem cell transplant (HSCT) or a solid organ transplant (SOT) "
Protocol code: TAK-620-2004
Sponsor: Takeda Development Center Americas Inc. (Pharmaceutical company). Phase: Therapeutic confirmatory (Phase III). Countries: Spain (ongoing, recruitment ended), Belgium (ongoing, recruitment ended), Germany (ongoing, recruitment ended), France (ongoing, recruitment ended).
Therapeutic area(s): Diseases [C] - Virus Diseases [C02]
Gender: Female, Male. Age: 0-17 years. Enrolment: 21.
Status: Ongoing, recruitment ended. Start date (EU): 2025-10-29. Decision date: 2024-04-22. Results received: No. Last updated: 2026-05-05.
Decision dates by country: FR: 2024-05-30, BE: 2024-04-22, DE: 2024-04-24, ES: 2024-04-22

Condition(s): Cytomegalovirus (CMV) infection in children and adolescents who have received a hematopoietic stem cell transplant (HSCT) or a solid organ transplant (SOT)
Product: maribavir, Maribavir, LIVTENCITY 200 mg film-coated tablets., Maribavir

Primary endpoint: PK at steady state 1 including max observed plasma concentration (Cmax), time when Cmaxis observed (Tmax), maribavir min concentration predose (Cmin),under plasma concentration-time curve over 1 dosing interval of 12hrs at steady state (AUC0-tau), half-life (t1/2), terminal elimination rate constant (λz), apparent vol of distribution (Vz/F), and apparent oral clearance (CL/F) based on PK samples collected Week1. Cminat Week4 (predose) and Week 8 (predose 2 to 4 hrs after the AM dose)., 2. Safety and tolerability assessments: serious adverse events (SAEs), adverse events (AEs) (including instances of CMV disease), vital signs, clinical laboratory evaluations at specified visits, ECGs, and discontinuations from the study drug/study.
Endpoint(s): 1. Achievement of the confirmed clearance of plasma CMV DNA (ie, plasma CMV DNA concentration below the lower limit of quantification (LLOQ) at a central specialty laboratory, in 2 consecutive postbaseline samples, separated by at least 5 days) at Week 8 regardless of the length of study treatment., 2. Maintenance of CMV viremia clearance and symptom control achieved at Week8 through Week 12 (4 weeks post-treatment period), Week16 (8 weeks post-treatment period), and Week20 (12weeks post-treatment period)., 3. Recurrence of CMV viremia while on study treatment and off study treatment.The proportion of subjects with confirmed recurrence of viremia while on study treatment and in the follow-up period after the subject is discontinued from study treatment, and the corresponding 95% CI will be calculated., 4. Time to first confirmed viremia clearance at any time during the study. – The time to first confirmed viremia clearance at any time during the study will be summarized using the Kaplan-Meier method., 5. Recurrence treated with alternative anti-CMV treatment in the 12- week follow-up period in subjects with confirmed viremia clearance at Week 8. – The proportion of subjects with confirmed recurrence of CMV viremia treated with alternative anti-CMV treatment in the 12-week follow-up period in subjects with confirmed viremia clearance at Week 8, and the corresponding 95% CI, will be calculated., 6. Changes in plasma CMV DNA load from baseline(Visit 2/Day0/Week0)by study week. –Change from baseline (Visit 2/Day 1/Week 0) in log10 plasma CMV DNA on study after receiving study treatment will be summarized descriptively.", 7. Maribavir CMV resistance profile. Details of the analysis will be specified in the resistance analysis plan., 8. Acceptability and palatability assessment of maribavir at Weeks 1, 4, and 8 (or end of treatment). – Palatability data will be summarized descriptively for each age cohort and overall at Weeks 1, 4, and 8 (or end of treatment)., continuation point 1. The proportion of subjects with confirmed CMV viremia clearance, at the end of Week 8, regardless of whether study treatment was discontinued early and the corresponding 95% CIs will be calculated for each age cohort and overall. Subjects who take alternative anti-CMV treatment before Week 8 or have missing data at Week 8 due to early discontinuation or any other reasons will be considered as nonresponders., continuation point 1 French translation, continuation point 2 part 1. The proportion of subjects who achieve maintenance of confirmed CMV viremia clearance and symptom control achieved at the end of Week 8 through to Week 12, Week 16, and Week 20 with the corresponding 95% CIs will be calculated for each age cohort and overall., continuation point 2 part 2. For clearance of CMV viremia achieved at the end of Week 8, regardless of whether study treatment was discontinued before the end of the stipulated 8 weeks of therapy, and maintenance of such effect through Week 12, Week 16, and Week 20, the subject must have received study treatment exclusively and must also have symptom control. Cytomegalovirus infection symptom control includes:, continuation point 2 part 3. - • Resolution or improvement of tissue invasive disease or CMV syndrome for symptomatic subjects at baseline (Visit 2/Day 1/Week 0) • No new symptoms for asymptomatic subjects at baseline (Visit 2/Day 1/Week 0)

Source: https://euclinicaltrials.eu/ctis-public/view/2023-508988-73-00